EU clinical trial 2024-519282-22-00: A Phase 3 Randomized, Open Label Study to Evaluate the Efficacy and Safety of Tobevibart+Elebsiran Combination Therapy in Participants with Chronic HDV Infection Not Virologically Suppressed with Bulevirtide (ECLIPSE 2)
Protocol code: VIR-CHDV-V205
Sponsor: Vir Biotechnology Inc. (Pharmaceutical company). Phase: Therapeutic confirmatory (Phase III). Countries: Romania (ongoing, recruitment ended), Austria (ongoing, recruitment ended), France (ongoing, recruitment ended), Spain (ongoing, recruitment ended), Italy (ongoing, recruitment ended), Germany (ongoing, recruitment ended).
Therapeutic area(s): Diseases [C] - Virus Diseases [C02]
Gender: Female, Male. Age: 18-64 years, 65+ years. Enrolment: 136.
Status: Ongoing, recruitment ended. Start date (EU): 2025-07-09. Decision date: 2025-05-26. Results received: No. Last updated: 2026-04-02.
Decision dates by country: RO: 2025-06-02, ES: 2025-06-02, AT: 2025-06-02, IT: 2025-05-28, FR: 2025-07-16, DE: 2025-05-28

Condition(s): Chronic Hepatitis D Virus (HDV) Infection
Product: VIR-2218, VIR-3434, HEPCLUDEX 2 mg powder for solution for injection

Primary endpoint: Part I: HDV RNA < LLOQ, TND at Week 24, Part 2: HDV RNA < LLOQ, TND 24 weeks after end of treatment
Endpoint(s): Part I: HDV RNA < LLOQ, TND at Week 48 and Week 96 Change from baseline in HDV RNA at Week 48 and Week 96, Part I: Change from baseline in ALT at Week 24, Week 48 and Week 96, Part I: Incidence of TEAEs and SAEs through Week 24, Week 48 and Week 96, Part I: • Incidence of decompensated cirrhosis (clinical event or CPT score ≥ 7) through Week 48 and Week 96 • Incidence of HCC or progression to liver failure requiring transplantation or resulting in death through Week 48 and Week 96, Part I: Change from baseline in liver stiffness as measured by liver elastography at Week 48 and Week 96, Part I: • Change from baseline in HBsAg at Week 24, Week 48 and Week 96 • Categorical summary of HBsAg at Week 24, Week 48 and Week 96, Part I: • ALT ≤ ULN and HDV RNA < LLOQ, TND at Week 24, Week 48 and Week 96 • ALT ≤ ULN at Week 24, Week 48 and Week 96, Part I: • ALT ≤ ULN and HDV RNA < LLOQ, TND at Week 24, Week 48 and Week 96 • ALT ≤ ULN at Week 24, Week 48 and Week 96, Part II: • HDV RNA < LLOQ, TND at Week 144, Week 192 and Week 240 • Change from baseline in HDV RNA from tobevibart+elebsiran interruption at Week 96 to Week 120, Week 144, Week 192 and Week 240, Part II: • HDV RNA < LLOQ, TND at Week 120, Week 144, Week 192 and Week 240 • Change from baseline in HDV RNA at Week 120, Week 144, Week 192 and Week 240, Part II: • Change from baseline in ALT from tobevibart+elebsiran interruption at Week 96 to Week 120, Week 144, Week 192 and Week 240, Part II: Incidence of AEs, SAEs and lab abnormalities from time of tobevibart+elebsiran interruption (Week 96) through Week 120, Week 144, Week 192 and Week 240., Part II: • Incidence of decompensation through Week 144, Week 192 and Week 240 • Incidence of HCC or progression to liver failure requiring transplantation or resulting in death through Week 144, Week 192 and Week 240, Part II: Change from baseline in liver stiffness as measured by liver elastography at Week 144, Week 192 and Week 240, Part II: Categorical summary of HBsAg at Week 120, Week 144, Week 192 and Week 240, Part II: TEAEs, SAEs through Week 120, Week 144, Week 192 and Week 240, Part II: • ALT ≤ ULN and HDV RNA < LLOQ, TND at Week 120, Week 144, Week 192 and Week 240 • ALT ≤ ULN at Week 120, Week 144, Week 192 and Week 240, Part II: ALT ≤ ULN and HDV RNA < LLOQ, TND at Week 120, Week 144, Week 192 and Week 240 • ALT ≤ ULN at Week 120, Week 144, Week 192 and Week 240

Source: https://euclinicaltrials.eu/ctis-public/view/2024-519282-22-00